EU clinical trial 2024-513645-37-00: BOTAF - Prevention of post-operative Atrial Fibrillation by BOTulinum toxin injections into epicardial fat pads around pulmonary veins in patients undergoing cardiac surgery
Protocol code: P170912J
Sponsor: Assistance Publique Hopitaux De Paris (Hospital/Clinic/Other health care facility). Phase: Therapeutic confirmatory (Phase III). Countries: France (ongoing, recruitment ended).
Therapeutic area(s): Diseases [C] - Cardiovascular Diseases [C14]
Gender: Female, Male. Age: 18-64 years, 65+ years. Enrolment: 220.
Status: Ongoing, recruitment ended. Start date (EU): 2024-09-05. Decision date: 2024-09-05. Results received: No. Last updated: 2024-11-19.

Condition(s): Adult patients with indication for conventional cardiac surgery (CABG, aortic replacement, or ascending aorta surgery)
Product: XEOMIN 200 unités, poudre pour solution injectable, Placebo of Xeomin 200 U

Primary endpoint: The incidence of rhythm disorders of postoperative AF in patients undergoing cardiac surgery at 3 weeks defined as atrial arrhythmia during at least 30 seconds continuously within 21 days after cardiac surgery. It will be measured through both holter ECG Spiderflash-t recorder during the first 21 days post-op and ECG daily monitoring during the first 7 days after surgery. Two blinded cardiologists will independently adjudicate the primary end point.

Source: https://euclinicaltrials.eu/ctis-public/view/2024-513645-37-00